EU clinical trial 2024-511587-93-00: Activity of Pembrolizumab plus Enfortumab Vedotin in Collecting Duct and Renal Medullary Carcinoma (REPRINT trial)
Protocol code: REPRINT
Sponsor: Fondazione IRCCS Istituto Nazionale Dei Tumori (Hospital/Clinic/Other health care facility). Phase: Therapeutic exploratory (Phase II). Countries: Italy (authorised, recruitment pending).
Therapeutic area(s): Diseases [C] - Neoplasms [C04]
Gender: Female, Male. Age: 18-64 years, 65+ years. Enrolment: 23.
Status: Authorised, recruitment pending. Decision date: 2025-02-12. Results received: No. Last updated: 2026-05-27.

Condition(s): Medullary Renal cell Carcinoma, Collecting Duct Carcinoma
Product: KEYTRUDA 25 mg/mL concentrate for solution for infusion, ENFORTUMAB VEDOTIN

Primary endpoint: The primary Efficacy Endpoint is Objective Response Rate (ORR)
Endpoint(s): The secondary endpoints of this study are progression-free survival (PFS), overall-survival (OS) and tolerability.

Source: https://euclinicaltrials.eu/ctis-public/view/2024-511587-93-00